EU clinical trial 2024-517640-57-01: PET imaging of CD8 T lymphocyte recruitment induced by radiotherapy locally and remotely
Sponsor: Commissariat a l'Energie Atomique et aux Energies Alternatives (Laboratory/Research/Testing facility). Phase: Human Pharmacology (Phase I)- First administration to humans. Countries: France (ongoing, recruiting).
Therapeutic area(s): Diseases [C] - Neoplasms [C04]
Gender: Female, Male. Age: 18-64 years. Enrolment: 20.
Status: Ongoing, recruiting. Start date (EU): 2025-01-24. Decision date: 2025-01-24. Results received: No. Last updated: 2025-01-24.

Condition(s): Patients with polymetastatic solid cancers.

Source: https://euclinicaltrials.eu/ctis-public/view/2024-517640-57-01